EU clinical trial 2023-508407-20-00: A Follow-Up Shiftability Study of Arbaclofen with an Open-Label Extension for the study of Biomarkers for Treatment for Social Function in Children and Adolescents with Autism Spectrum Disorders
Protocol code: AIMS-2-CT2
Sponsor: Fundacion Para La Investigacion Biomedica Del Hospital Gregorio Maranon (Hospital/Clinic/Other health care facility). Phase: Therapeutic confirmatory (Phase III). Countries: Spain (ongoing, recruiting), France (ongoing, recruiting).
Therapeutic area(s): Psychiatry and Psychology [F] - Behavior and Behavior Mechanisms [F01]
Gender: Female, Male. Age: 0-17 years, 18-64 years. Enrolment: 105.
Status: Ongoing, recruiting. Start date (EU): 2025-11-20. Decision date: 2024-09-23. Results received: No. Last updated: 2026-06-09.
Decision dates by country: FR: 2024-09-30, ES: 2024-09-23

Condition(s): autism spectrum disorder
Product: ARBACLOFEN 10mg, ARBACLOFEN 5mg, ARBACLOFEN 15mg, ARBACLOFEN 20mg

Primary endpoint: Change in power in the low frequency bands (theta/alpha) (between visits 1 and 2).
Endpoint(s): Latency of N170 change (between visits 1 and 2)

Source: https://euclinicaltrials.eu/ctis-public/view/2023-508407-20-00